EU clinical trial 2023-503233-22-00: Randomized, Open-label, Single-Dose, Two-treatment, Two-period, Cross-over, Pivotal Bioequivalence Study Comparing Amoxicilin/Clavulanic acid powder for oral suspension 600 mg/42.9 mg/5 mL to Augmentin ES 600 mg/42.9 mg/5 mL powder for oral suspension in Healthy Adult Male and Female Volunteers under Fed Conditions.
Protocol code: 01-AMO-CLA-BIO-22
Sponsor: Tarchominskie Zaklady Farmaceutyczne Polfa S.A. (Pharmaceutical company). Phase: Human Pharmacology (Phase I)- Bioequivalence Study. Countries: Czechia (ended).
Therapeutic area(s): Diseases [C] - Bacterial Infections and Mycoses [C01]
Gender: Female, Male. Age: 18-64 years. Enrolment: 56.
Status: Ended. Start date (EU): 2023-09-27. End date (EU): 2023-11-13. Decision date: 2023-08-24. Results received: Yes. Last updated: 2023-08-24.

Condition(s): Not applicable (submitted trial is a bioequivalence study in healthy subjects).
Product: Amoxicillin/Clavulanic acid, Heparin Léčiva Injekční roztok, Augmentin ES, (600 mg + 42,9 mg)/5 ml, proszek do sporządzania zawiesiny doustnej

Primary endpoint: AUC(0-t), and Cmax of AXL and CLA
Endpoint(s): tmax, λz, t1/2, AUC(0-∞) and AUCres of AXL and CLA

Source: https://euclinicaltrials.eu/ctis-public/view/2023-503233-22-00